EU clinical trial 2023-510089-28-00: Combinatory ImmunoTherapy-2 (Com-IT-2) A phase 2 randomised open two-arm study to assess the tolerability and efficacy of immunotherapy combined with extensive radiotherapy for the treatment of stage IV non-small cell lung cancer
Sponsor: Oslo University Hospital HF (Hospital/Clinic/Other health care facility). Phase: Phase I and Phase II (Integrated)- Other. Countries: Norway (ongoing, recruiting).
Therapeutic area(s): Diseases [C] - Pathological Conditions, Signs and Symptoms [C23]
Gender: Female, Male. Age: 18-64 years, 65+ years. Enrolment: 55.
Status: Ongoing, recruiting. Start date (EU): 2024-05-22. Decision date: 2024-05-21. Results received: No. Last updated: 2025-06-20.

Condition(s): Non-small cell lung cancer (Stage IV)
Product: Tecentriq 1 200 mg concentrate for solution for infusion, KEYTRUDA 25 mg/mL concentrate for solution for infusion, OPDIVO 10 mg/mL concentrate for solution for infusion., LIBTAYO 350 mg concentrate for solution for infusion.

Primary endpoint: The primary objective is to evaluate the acute toxicity (<3 months) and subacute toxicity (3-6 months) toxicity) of immunotherapy combined with extensive radiotherapy in patients with stage IV NSCLC compared with immunotherapy without radiotherapy.
Endpoint(s): Adverse events and laboratory values will be graded according to the NCI-CTCAE version 5.0. and published, Response will be evaluated by iRECIST 1.1 and RECIST 1.1. Survival data (PFS and OS) and response rates (RR and DOR) will be evaluated and published., HRQoL will be evaluated at baseline, end of radiotherapy and at 3 and 6 months for both study arms and published.

Source: https://euclinicaltrials.eu/ctis-public/view/2023-510089-28-00